EU clinical trial 2024-518289-28-00: A Multinational, Long-Term, Open-Label Extension Study of Subjects Who Have Participated in Avalyn Pharma Studies of Inhaled Antifibrotic Agents (AP-LTE-008 [Sail])
Protocol code: AP-LTE-008
Sponsor: Avalyn Pharma Inc. (Pharmaceutical company). Phase: Therapeutic exploratory (Phase II). Countries: Poland (ongoing, recruiting), Netherlands (ongoing, recruiting), Czechia (ongoing, recruiting), France (ongoing, recruiting), Spain (ongoing, recruiting), Italy (ongoing, recruiting), Germany (authorised, recruiting).
Therapeutic area(s): Diseases [C] - Respiratory Tract Diseases [C08]
Gender: Female, Male. Age: 18-64 years, 65+ years. Enrolment: 121.
Start date (EU): 2025-07-04. Decision date: 2025-06-03. Results received: No. Last updated: 2026-07-24.
Decision dates by country: ES: 2025-09-05, PL: 2025-06-25, CZ: 2025-06-25, DE: 2025-09-19, NL: 2025-06-04, IT: 2025-09-19, FR: 2025-09-12

Condition(s): Progressive pulmonary fibrosis [PPF] Idiopathic pulmonary fibrosis [IPF]
Product: Pirfenidone Solution for Inhalation

Primary endpoint: Incidence of treatment-emergent adverse events (TEAEs) and serious adverse events (SAEs), Incidence of adverse events of special interest (AESIs), Incidence of treatment-emergent all-cause deaths, Incidence of treatment-emergent respiratory deaths, Incidence of exacerbation of pulmonary fibrosis, Changes from baseline in clinical laboratory tests and vital signs
Endpoint(s): Change from baseline in forced vital capacity (FVC) (mL) at intervals of 6 months, Annual rate of decline in FVC (mL)

Source: https://euclinicaltrials.eu/ctis-public/view/2024-518289-28-00